EU clinical trial 2024-520319-42-01: A Randomized, Delayed-Treatment Controlled, Phase 2 Pilot Study of Manualized MDMA-Assisted Therapy for Young Adults with Chronic Treatment-Resistant Major Depressive Disorder
Protocol code: EMPATHY
Sponsor: Ostfold Hospital Trust (Hospital/Clinic/Other health care facility). Phase: Therapeutic exploratory (Phase II). Countries: Norway (authorised, recruitment pending).
Therapeutic area(s): Psychiatry and Psychology [F] - Psychological Phenomena [F02]; Psychiatry and Psychology [F] - Mental Disorders [F03]
Gender: Female, Male. Age: 18-64 years. Enrolment: 16.
Status: Authorised, recruitment pending. Decision date: 2026-07-03. Results received: No. Last updated: 2026-07-03.

Condition(s): Major Depressive Disorder
Product: Midomafetamine

Primary endpoint: Recruitment and retention, Moderate to severe adverse events, Adverse event of special interest and Serious adverse events
Endpoint(s): Between-group difference in depression severity, Between-group difference in functional impairment severity

Source: https://euclinicaltrials.eu/ctis-public/view/2024-520319-42-01